EU clinical trial 2025-524139-38-00: A Phase 2, Open-label Study to Evaluate the Safety, Tolerability, Pharmacokinetics, and Efficacy of Surovatamig in Adults with Antibody-mediated Kidney Disease
Protocol code: D740FC00001
Sponsor: AstraZeneca AB (Pharmaceutical company). Phase: Therapeutic exploratory (Phase II). Countries: France (authorised, recruitment pending), Germany (authorised, recruitment pending), Italy (authorised, recruitment pending), Belgium (authorised, recruitment pending), Poland (authorised, recruitment pending), Spain (authorised, recruitment pending).
Therapeutic area(s): Diseases [C] - Immune System Diseases [C20]
Gender: Female, Male. Age: 18-64 years, 65+ years. Enrolment: 17.
Status: Authorised, recruitment pending. Decision date: 2026-07-13. Results received: No. Last updated: 2026-07-20.
Decision dates by country: BE: 2026-07-13, FR: 2026-07-20, DE: 2026-07-20, IT: 2026-07-15, ES: 2026-07-17, PL: 2026-07-20

Condition(s): Antibody-mediated Kidney Disease
Product: AZD0486, AZD0486

Primary endpoint: • Incidence and severity of AEs, SAEs, and AESIs • AEs/SAEs leading to discontinuation of surovatamig • Vital signs • Physical examination • Laboratory parameters • 12-lead ECG, Change from baseline in UPCR (from 24-hour urine collection or the intended 24-hour urine collection) at 6 months.
Endpoint(s): Percentage of participants achieving complete or partial remission of pMN at 24 months −Complete remission: reduction of proteinuria from baseline to a value ≤ XX g/24 h plus stable kidney function −Partial remission: reduction of proteinuria > XX from baseline and a value < XX g/24 h plus stable kidney function. Note: A stable kidney function is defined as a GFR that remains unchanged or declines by < XX., Percentage of participants achieving complete remission of pMN at 24 months. Percentage of participants achieving partial remission of pMN at 24 months., Change from baseline in UPCR (from 24-hour urine collection or the intended 24-hour urine collection) to 24 months, Change from baseline in anti-PLA2R antibody titer to 24 months, Change from baseline in B-cell count in peripheral blood to 24 months, Time to relapse after complete or partial remission up to 24 months, Time to a ≥ 3 months sustained reduction of eGFR ≥ XX from baseline up to 24 months, Change from baseline in Patient Reported Outcome, Serum PK parameters of surovatamig, including but not limited to AUC and Cmax, Treatment-emergent ADAs

Source: https://euclinicaltrials.eu/ctis-public/view/2025-524139-38-00